EU clinical trial 2024-518017-26-00: Trastuzumab Deruxtecan (T-DXd): Tailoring Treatment and Companion Diagnostics (CDx) by Liquid Biopsy. DIAMOND STUDY
Protocol code: ESR-21-21447
Sponsor: Fondazione Policlinico Universitario Agostino Gemelli IRCCS (Hospital/Clinic/Other health care facility). Phase: Therapeutic exploratory (Phase II). Countries: Italy (ongoing, recruitment ended).
Therapeutic area(s): Diseases [C] - Neoplasms [C04]
Gender: Female, Male. Age: 18-64 years, 65+ years. Enrolment: 22.
Status: Ongoing, recruitment ended. Start date (EU): 2023-11-07. Decision date: 2024-11-11. Results received: No. Last updated: 2025-07-21.

Condition(s): metastatic HER2-positive breast cancer patients
Product: TRASTUZUMAB DERUXTECAN

Primary endpoint: Concordance in progression between RECIST v1.1 and CTDNA at 1 year after the start of treatment. CTDNA will be categorised as either presence or no presence of circulating genomic alterations associated with pharmacological resistance and susceptibility to T-DXd.Genomic alterations will be considered as new appearance and/or increasing of existing alterations
Endpoint(s): Listing of circulating alterations during treatment and at progression: particularly those actionable at OncoKB level 3A/B or lower, particularly when ctDNA-only, Liquid biopsy Lead Time Progression Free survival (PFS-LB) compared to medical imaging, Lead Time is defined as the time to progression by RECIST1.1 criteria (PFS-R) - (minus, subtraction) the time to progression by circulating tumor DNA, e.g. PFS-ctDNA. Days of Lead Time = days PFS-R - days PFS-ctDNA, PFS assessed between two groups of patients in relation with HER2-2D: HER2 status lower vs higher detected by LB, Safety endpoint: Toxicity will be graded according to NCICTCAE vers. 5.0, Exploratory endpoint: Presence of tissue genomic alterations (from primary or last available tumor tissue) associated with pharmacological resistance and susceptibility to T-DXd to be compared with those found on liquid biopsy

Source: https://euclinicaltrials.eu/ctis-public/view/2024-518017-26-00